EU clinical trial 2024-519993-38-00: NeoTISLEGA - A phase Ib trial evaluating the safety and activity of neoadjuvant combination of tislelizumab plus FLOT for resectable esophagogastric adenocarcinoma
Sponsor: Frankfurter Institut Fuer Klinische Krebsforschung IKF GmbH (Pharmaceutical company). Phase: Human Pharmacology (Phase I)- Other. Countries: Germany (ongoing, recruiting).
Therapeutic area(s): Diseases [C] - Digestive System Diseases [C06]; Diseases [C] - Neoplasms [C04]
Gender: Female, Male. Age: 18-64 years, 65+ years. Enrolment: 18.
Status: Ongoing, recruiting. Start date (EU): 2025-12-12. Decision date: 2025-08-27. Results received: No. Last updated: 2026-05-21.
Decision dates by country: DE: 2025-11-03

Condition(s): resectable esophagogastric adenocarcinoma

Source: https://euclinicaltrials.eu/ctis-public/view/2024-519993-38-00